EU clinical trial 2025-524759-29-00: COLOMBE - A multicentre, single arm, phase 1/2 study, aiming to assess the safety and efficacy of nivolumab and imiquimod combination in vulvar squamous cell carcinoma patients
Protocol code: ET25-408
Sponsor: Centre Leon Berard (Hospital/Clinic/Other health care facility). Phase: Phase I and Phase II (Integrated)- Other. Countries: France (authorised, recruitment pending).
Therapeutic area(s): Diseases [C] - Neoplasms [C04]; Diseases [C] - Female Urogenital Diseases and Pregnancy Complications [C13]
Gender: Female. Age: 18-64 years, 65+ years. Enrolment: 50.
Status: Authorised, recruitment pending. Decision date: 2026-04-22. Results received: No. Last updated: 2026-04-22.

Condition(s): Vulvar Squamous Cell Carcinoma (VSCC) patients
Product: OPDIVO 10 mg/mL concentrate for solution for infusion., ALDARA 5% cream

Primary endpoint: Safety run-in: Dose-limiting toxicity (DLT) defined as any adverse event (AE) related to imiquimod and/or nivolumab, occurring during the induction period (first 6 weeks of treatment, i.e., DLT period) and graded according to the NCI-CTCAE V6.0 classification (see protocol), Phase 2: Clinical ORR as per RECIST 1.1 category documented by calipers using standardized digital photography with reference ruler at the time of surgery
Endpoint(s): Pathological response: The pathological tumor response (pTR) is defined as the presence of tumor cell necrosis and keratinous debris with giant cell/histiocytic reaction, quantified as a percentage of the overall tumor bed (area pathologic response/area pathologic response plus viable tumor): pTR-0 (<10%), pTR-1 (10%-49%), pTR-2 (≥50%), pTR-3 (100%, complete response) The pTR will be quantified in increments of 10%., Rate of patients with positive margin defined as <8mm, Rate of patients with positive Sentinel Lymph Node (SLN), Rate of patients undergoing radiotherapy, Surgical complications: see section 7.7 of protocol, Overall Survival (OS): defined as the time between treatment initiation (C1D1) and death from any cause. Patients still alive at the time of analysis will be censored at the date of last news they are known to be alive., Recurrence Free Survival (RFS): defined as the time from C1D1 to the first documented disease recurrence or death from any cause, whichever occurs first. Patients who are alive and without evidence of recurrence at the time of analysis will be censored at the date of their last disease assessment., Quality of life questionnaire (EORTC QLQ C-30 and QLQ-VU34), Safety: Incidence and severity of AE according to NCI CTCAE V6.0

Source: https://euclinicaltrials.eu/ctis-public/view/2025-524759-29-00